EU clinical trial 2024-515224-37-00: Perioperative/Adjuvant atezolizumab in patients with MSI-high or MMRdeficient stage II high risk or stage III colorectal cancer ineligible for oxaliplatin-based chemotherapy– a Phase II study (ANTONIO)
Protocol code: AIO-KRK-0220
Sponsor: AIO-Studien gGmbH (Laboratory/Research/Testing facility). Phase: Therapeutic exploratory (Phase II). Countries: Germany (ongoing, recruitment ended).
Therapeutic area(s): Diseases [C] - Neoplasms [C04]
Gender: Female, Male. Age: 18-64 years, 65+ years. Enrolment: 80.
Status: Ongoing, recruitment ended. Start date (EU): 2023-08-29. Decision date: 2024-08-19. Results received: No. Last updated: 2026-07-23.

Condition(s): Patients with MSI-high or MMR-deficient stage III colorectal cancer who are ineligible for or who refuse oxaliplatin-based chemotherapy after R0 tumor resection (main study) or planned resection (sub-study)
Product: Tecentriq 840 mg concentrate for solution for infusion, Tecentriq 1 200 mg concentrate for solution for infusion, IMM-101

Primary endpoint: The primary efficacy endpoint is disease-free survival (DFS) rate at 3 years, defined as the proportion of patients without relapse or tumor-related death from any cause 3 years after start of treatment in the intention-to-treat population., For the sub-study: Pathological complete (pCR) or subtotal (<10% vital tumor cells) regression (measured in resected tumors) after completion of 5 weeks of neoadjuvant treatment., incidence, severity and causality/ relationship of adverse events (AEs), serious adverse events (SAEs) and adverse events of special interest (AESI)
Endpoint(s): DFS including 1-, and 2-year tumor-specific DFS rates, Overall Survival (OS) including 1-, 2- and 3-year OS rates, Rate of patients without detectable ctDNA after 12 months. ctDNA-free is defined as a ctDNA level below the lowest limit of detection of the respective Liquid Biopsy Assay, QoL

Source: https://euclinicaltrials.eu/ctis-public/view/2024-515224-37-00